EU clinical trial 2023-509026-21-00: A prospective, real-world, interventional study to evaluate the effect of mepolizumab on achieving clinical remission in participants with severe asthma.
Protocol code: 219871
Sponsor: Glaxosmithkline Research & Development Limited (Pharmaceutical company). Phase: Therapeutic use (Phase IV). Countries: Italy (ongoing, recruitment ended), Belgium (ongoing, recruitment ended), France (ongoing, recruitment ended), Spain (ongoing, recruitment ended), Germany (ongoing, recruitment ended), Poland (ongoing, recruitment ended).
Therapeutic area(s): Diseases [C] - Respiratory Tract Diseases [C08]
Gender: Female, Male. Age: 18-64 years, 65+ years. Enrolment: 170.
Status: Ongoing, recruitment ended. Start date (EU): 2024-06-03. Decision date: 2024-05-14. Results received: No. Last updated: 2025-12-10.
Decision dates by country: FR: 2024-05-14, DE: 2024-05-14, BE: 2024-05-14, ES: 2024-05-14, IT: 2024-05-14, PL: 2024-05-15

Condition(s): severe asthma
Product: Nucala 100 mg solution for injection in pre-filled pen, Nucala 100 mg solution for injection in pre-filled syringe, Nucala 100 mg solution for injection in pre-filled syringe, Nucala 100 mg solution for injection in pre-filled pen, Nucala 100 mg solution for injection in pre-filled pen, Nucala 100 mg solution for injection in pre-filled syringe

Primary endpoint: 1. Endpoint: Achieving 4-component clinical remission Summary Measure: Proportion and 95% confidence interval of patients that achieved clinical remission at 12 months
Endpoint(s): 1. • Clinically Significant Asthma Exacerbations (CSE) • CSE leading to hospitalization/Emergency room (ER) visits 2. • Achieving oral corticosteroids (OCS) sparing remission • Achieving 3-component clinical remission 3. Change in the 15-item mini-AQLQ overall score from baseline to 12 months

Source: https://euclinicaltrials.eu/ctis-public/view/2023-509026-21-00